EU clinical trial 2025-523549-92-00: Melatonin versus placebo for bipolar disorder - a double blinded randomised controlled trial (The M-bipolar RCT)
Sponsor: Region Hovedstaden (Hospital/Clinic/Other health care facility). Phase: Phase III and phase IV (Integrated). Countries: Denmark (ongoing, recruiting).
Therapeutic area(s): Psychiatry and Psychology [F] - Mental Disorders [F03]
Gender: Female, Male. Age: 18-64 years. Enrolment: 200.
Status: Ongoing, recruiting. Start date (EU): 2026-04-16. Decision date: 2026-01-16. Results received: No. Last updated: 2026-01-16.

Condition(s): Bipolar disorder
Product: PLACEBO, Orimelan 3 mg tabletter

Primary endpoint: Mood stabilization will be measured by a mood instability score reflecting the daily variability in self-monitored mood collected via the Monsenso system
Endpoint(s): Hamilton D6, Pittsburgh Sleep Quality, Young Mania Rating Scale, Functioning Assessment Short Test (FAST), internet-based Cognition Assessment Tool (ICAT) and bloodbased inflammation markers in bloodsamples, hair cortisol and urine oxidative stress markers

Source: https://euclinicaltrials.eu/ctis-public/view/2025-523549-92-00